EU clinical trial 2024-515531-29-00: Bioequivalence clinical trial of two formulations of loperamide.
Protocol code: N-LOP-24-289
Sponsor: Laboratorios Normon S.A. (Pharmaceutical company). Phase: Human Pharmacology (Phase I)- Bioequivalence Study. Countries: Spain (ended).
Therapeutic area(s): Not possible to specify
Gender: Female, Male. Age: 18-64 years. Enrolment: 36.
Status: Ended. Start date (EU): 2024-11-04. End date (EU): 2024-12-03. Decision date: 2024-10-31. Results received: No. Last updated: 2024-10-31.

Condition(s): Healthy volunteers

Source: https://euclinicaltrials.eu/ctis-public/view/2024-515531-29-00